EU clinical trial 2024-511181-36-00: A Randomized, Controlled, Masked, Multi-center Study Evaluating the Efficacy, Safety, and Tolerability of Two Doses of AGTC-501 Compared to an Untreated Control Group in Male Participants with X-linked Retinitis Pigmentosa
Protocol code: AGTC-RPGR-002
Sponsor: Beacon Therapeutics (USA) Inc. (Pharmaceutical company). Phase: Therapeutic confirmatory (Phase III). Countries: Spain (not authorised).
Therapeutic area(s): Diseases [C] - Eye Diseases [C11]
Gender: Male. Age: 0-17 years, 18-64 years. Enrolment: 5.
Status: Not authorised. Decision date: 2024-09-17. Results received: No. Last updated: 2024-09-17.

Condition(s): X-linked retinitis pigmentosa (XLRP)
Product: PREDNISOLONE, ACETAZOLAMIDE, PREDNISONE, AGTC-501, PREDNISOLONE ACETATE, BRINZOLAMIDE, TIMOLOL MALEATE, ACICLOVIR, TRIAMCINOLONE ACETONIDE, DORZOLAMIDE, VALACICLOVIR, DORZOLAMIDE HYDROCHLORIDE

Primary endpoint: The primary efficacy endpoint in Europe is the change from baseline in mean sensitivity across the whole grid, as measured by MAIA microperimetry, at Month 12
Endpoint(s): Change from baseline in mobility test score at Month 12 as measured by the Ora-VNC mobility course, Change from baseline in mean sensitivity across the whole grid, as measured by MAIA microperimetry at Month 18, Response at Month 12, as measured by MAIA microperimetry, where response is defined as a ≥7 decibel (dB) visual sensitivity improvement from baseline in at least 5 loci, Change from baseline in mobility test score at Month 12 as measured by the MObility Standardized Test-Virtual Reality (MOST-VR) mobility course, Change from baseline in full-field stimulus threshold (FST) at Month 12, Change from baseline in mean sensitivity across the central 4 loci, as measured by MAIA microperimetry, at Month 12, Proportion of participants with a ≥15 letter increase from baseline in LLVA at Month 18 and 24, Change in low-luminance deficit (LLD), defined as the difference between BCVA and LLVA Month 12, Change from baseline in BCVA over time as assessed by an Early Treatment of Diabetic Retinopathy (ETDRS) or Tumbling E chart at Month 12, Response by Ora-VNC where response is defined as a mobility test score increase of 2 or more luminance levels at Month 12, Change from baseline in mean sensitivity across the whole grid, as measured by MAIA microperimetry at Month 24, Response at Month 18 and 24, as measured by MAIA microperimetry, where response is defined as a ≥7 decibel (dB) visual sensitivity improvement from baseline in at least 5 loci, Change from baseline in full-field stimulus threshold (FST) at Month 24, Change from baseline in mean sensitivity across the central 4 loci, as measured by MAIA microperimetry, at Month 18 and Month 24, Proportion of participants with a ≥10 letter increase from baseline in LLVA at Month 12, 18 and 24, Change in low-luminance deficit (LLD), defined as the difference between BCVA and LLVA Month 18 and 24, Change from baseline in BCVA over time as assessed by an Early Treatment of Diabetic Retinopathy (ETDRS) or Tumbling E chart at Month 18 and 24, Change from baseline in mobility test score at Month 18 and 24 as measured by the Ora-VNC mobility course, Response by Ora-VNC where response is defined as a mobility test score increase of 2 or more luminance levels at Month 18 and 24, Efficacy: Change from baseline in spectral-domain optical coherence tomography (SD-OCT) EZ line over time, Efficacy: Response over time, as measured by MAIA microperimetry, defined as ≥7 dB visual sensitivity improvement from baseline in 5 prespecified loci, Efficacy: Change from baseline in domain scores from the Michigan Retinal Degeneration Questionnaire (MRDQ), over time, Safety: The primary safety endpoint is the number and proportion of participants with ocular/non-ocular AEs

Source: https://euclinicaltrials.eu/ctis-public/view/2024-511181-36-00